EU clinical trial 2023-505239-10-00: Multi-Omics to predict the blood pressure response to antihypertensives
Protocol code: 114516
Sponsor: Stichting Radboud University Medical Center (Hospital/Clinic/Other health care facility). Phase: Therapeutic use (Phase IV). Countries: Netherlands (ongoing, recruiting).
Therapeutic area(s): Diseases [C] - Cardiovascular Diseases [C14]
Gender: Female, Male. Age: 18-64 years, 65+ years. Enrolment: 66.
Status: Ongoing, recruiting. Start date (EU): 2024-03-19. Decision date: 2023-09-14. Results received: No. Last updated: 2026-07-13.

Condition(s): Primary (essential) hypertension
Product: Olmesartan medoxomil/Amlodipine Aurobindo 20 mg/5 mg, filmomhulde tabletten, Amlodipine (als besilaat) Sandoz 10 mg, tabletten, Olmesartan medoxomil Glenmark 40 mg filmomhulde tabletten, Hydrochloorthiazide Mylan 25 mg, tabletten

Primary endpoint: Predictive value of a MOMICs profile to discriminate subjects with a decrease in 24-hour blood pressure below the median from subjects with a decrease in 24-hour blood pressure above the median for each treatment group (olmesartan, amlodipine, hydrochlorothiazide, olmesartan/amlodipine).
Endpoint(s): Predictive value of a MOMICs profile to discriminate subjects with a decrease in night-time blood pressure below the median from subjects with a decrease in 24-hour blood pressure above the median, for each treatment group (olmesartan, amlodipine, hydrochlorothiazide, olmesartan/amlodipine)., Correlation between changes in individual biomarkers and adverse effects as documented using adverse effects questionnaire and SF-36

Source: https://euclinicaltrials.eu/ctis-public/view/2023-505239-10-00